EU clinical trial 2024-516651-41-00: CORTICOP_Comparison of corticosteroids versus placebo on duration of ventilatory support during severe acute exacerbations of COPD patients in the intensive care unit: a multicentre randomized controlled trial
Protocol code: PHRC-2018-0127
Sponsor: Centre Hospitalier De Versailles (Hospital/Clinic/Other health care facility). Phase: Therapeutic confirmatory (Phase III). Countries: France (ongoing, recruitment ended).
Therapeutic area(s): Diseases [C] - Respiratory Tract Diseases [C08]
Gender: Female, Male. Age: 18-64 years, 65+ years. Enrolment: 440.
Status: Ongoing, recruitment ended. Start date (EU): 2021-10-08. Decision date: 2024-09-12. Results received: No. Last updated: 2025-09-23.

Condition(s): COPD : chronic obstructive Pulmonary disease
Product: METHYLPREDNISOLONE VIATRIS 120 mg, poudre pour solution injectable (IM-IV), SODIUM CHLORURE 0,9 % BIOLUZ, solution injectable, poche

Primary endpoint: Number of ventilator-free days (VFD) and alive.
Endpoint(s): NIV failure rate, defined by intubation, Duration of NIV and of invasive mechanical ventilation, Circulatory support-free days and alive at day 28, Severe hyperglycemia requiring intravenous insulin before day 5, Gastro-intestinal bleeding: acute loss of 2 g/dL of hemoglobin requiring red blood cell transfusion or gastroscopic evaluation, Uncontrolled arterial hypertension: unusual hypertension requiring to introduce/add antihypertensive medication (compared to usual medications), ICU acquired weakness (MRC-score) assessed on day 28 or at the time of ICU discharge, ICU-acquired infections (especially Ventilator-Associated Pneumonia), Length of ICU and hospital stay, ICU and hospital mortality, Day 28 and Day 90 mortality, Standardized mortality ratio (SMR), Number of new exacerbation(s)/hospitalization(s) between hospital discharge and Day 90, Dyspnea and comfort (patient reported outcome) at Day 90

Source: https://euclinicaltrials.eu/ctis-public/view/2024-516651-41-00